EU clinical trial 2024-513458-31-00: The Dominantly Inherited Alzheimer Network Trials Unit (DIAN-TU) Amyloid Removal Trial (ART): A Phase IIIb/IV Open-Label Study of Lecanemab to Evaluate Prevention and Progression of Dominantly Inherited Alzheimer’s Disease
Protocol code: DIAN-TU-003
Sponsor: Washington University School Of Medicine (Educational Institution). Phase: Phase III and phase IV (Integrated). Countries: France (ended).
Therapeutic area(s): Diseases [C] - Nervous System Diseases [C10]
Gender: Female, Male. Age: 18-64 years, 65+ years. Enrolment: 4.
Status: Ended. End date (EU): 2025-05-02. Decision date: 2024-10-11. Results received: No. Last updated: 2024-12-17.

Condition(s): Dominantly Inherited Alzheimer Disease (DIAD)
Product: Lecanemab

Primary endpoint: The primary and secondary endpoints measures will be collected through the DIAN Obs protocol. The primary endpoint for the interim analysis is the change from ART baseline to year 1 or year 2 in amyloid Pittsburgh compound B (PiB) PET standardized uptake value ratio (SUVR). The primary endpoint for the final analysis is the time to recurrent progression of Clinical Dementia Rating – Sum of Boxes (CDR-SB).
Endpoint(s): The secondary endpoint analysis will be the change from ART baseline to year 5 in the following assessments: imaging (amyloid PET, tau PET), clinical (Functional Assessment Scale), plasma and CSF biomarkers of disease progression including Aβ42/40, tau species (%phosphorylated tau217, 205, 231), total tau, and microtubule-binding region (MTBR) species, e.g. MTBR-243. These assessments are collected at the initial DIAN Obs Visit (which coincides with DIAN‐TU‐003 V2) and...Truncated due to limit

Source: https://euclinicaltrials.eu/ctis-public/view/2024-513458-31-00